EU clinical trial 2023-506524-82-00: A Phase III, double-blind, randomized, placebo-controlled multi-centre, study to assess the efficacy and safety of AZD9291 versus Placebo, in patients with Epidermal Growth Factor Receptor Mutation Positive stage IB-IIIA non-small cell lung carcinoma, following complete tumour resection with or without adjuvant chemotherapy (ADAURA)
Protocol code: ADAURA - D5164C00001
Sponsor: Astrazeneca AB (Pharmaceutical company). Phase: Therapeutic confirmatory (Phase III). Countries: Belgium (ended), Germany (ended), Sweden (ended), Spain (ended), Italy (ended), Poland (ended), France (ended).
Therapeutic area(s): Analytical,Diagnostic,Therapeutic Techniques and Equipment [E]-Surgical Procedures, Operative [E04]; Diseases [C] - Hemic and Lymphatic Diseases [C15]; Psychiatry and Psychology [F] - Behavioral Disciplines and Activities [F04]; Diseases [C] - Neoplasms [C04]
Gender: Female, Male. Age: 18-64 years, 65+ years. Enrolment: 70.
Status: Ended. Start date (EU): 2015-10-21. End date (EU): 2026-05-04. Decision date: 2024-06-20. Results received: No. Last updated: 2025-04-17.
Decision dates by country: BE: 2024-06-20, SE: 2024-06-20, DE: 2024-06-21, ES: 2024-06-24, IT: 2024-07-01, FR: 2024-06-20, PL: 2024-07-15

Condition(s): Stage IB-IIIA non-small cell lung carcinoma, with a centrally confirmed, common sensitising EGFR mutations (Ex19del and L858R either alone or in combination with other EGFR mutations), following complete tumour resection with or without adjuvant chemotherapy
Product: TAGRISSO 80 mg film-coated tablets, TAGRISSO 40 mg film-coated tablets, PLACEBO

Primary endpoint: Disease free survival (DFS) using investigator assessments.
Endpoint(s): Assessment of Disease free survival (DFS) rate at 2 years, 3 years, 4 years and 5 years., Analysis of Overall Survival (OS), Assessment of Overall Survival (OS) rate at 2 years, 3 years, 4 years and 5 years., Assessing of patient health-related quality of life and symptoms (HRQoL) using SF-36 questionnaire (version 2, standard), PK exposure parameters derived from plasma concentrations of Osimertinib and metabolites AZ5104 and AZ7550. Pharmacokinetics data from this study will be analysed using a population PK approach and may also form part of a pooled analysis with other Osimertinib studies; results from these analyses will be reported separately from the CSR., Safety and tolerability endpoints assessed by number and severity of adverse events, clinical chemistry, haematology, urinalysis, vital signs, physical examination, body weight, digital electrocardiogram (ECG), left Ventricular Ejection Fraction (LVEF), World Health Organization (WHO) Performance Status and Ophthalmologic assessment.

Source: https://euclinicaltrials.eu/ctis-public/view/2023-506524-82-00